EU clinical trial 2023-504342-55-00: INTERVENTIONAL PLATFORM STUDY INVESTIGATING THE IMPACT OF DIGITAL HEALTH SOLUTIONS ON HEALTH OUTCOMES AND HEALTH-CARE RESOURCE UTILIZATION IN PARTICIPANTS RECEIVING SYSTEMIC TREATMENT IN CLINICAL PRACTICE (ORIGAMA)
Protocol code: MO42720
Sponsor: F. Hoffmann-La Roche AG (Pharmaceutical company). Phase: Phase II and Phase III (Integrated). Countries: Austria (ended), Spain (ended), Germany (ended).
Therapeutic area(s): Diseases [C] - Neoplasms [C04]
Gender: Female, Male. Age: 18-64 years, 65+ years. Enrolment: 90.
Status: Ended. Start date (EU): 2023-02-02. End date (EU): 2024-06-19. End date: 2024-07-01. Decision date: 2024-02-20. Results received: Yes. Last updated: 2024-02-27.
Decision dates by country: AT: 2024-02-27, DE: 2024-02-20, ES: 2024-02-23

Condition(s): Cohort A: • Metastatic non-small cell lung carcinoma (mNSCLC); • Extensive-stage small-cell lung carcinoma (ES-SCLC); • Advanced or unresectable hepatocellular carcinoma (HCC); Cohort B: • Resected Stage IIB-IIIB (early-stage; per the UICC/AJCC staging system, 8th edition) non-small cell lung carcinoma (NSCLC)
Product: RO5541267

Primary endpoint: 1. Mean difference in change of Week 12 value from baseline of the participant-reported Total Symptom Interference Score from the MD Anderson Symptom Inventory (MDASI) Core Items, 2. At-home treatment adoption at Cycle 6
Endpoint(s): 1. Number of hospitalizations and number of cumulative days hospitalized due to serious adverse events (SAEs), 2. Unscheduled visits to the emergency room (ER) or clinic visits for symptom management, 3. Incidence, nature, and severity of all anti-cancer treatment associated adverse event (AEs) graded according to the National Cancer Institute Common Terminology Criteria for Adverse Events (NCI-CTCAE) v5.0 with additional analyses on Grade >= 3 AEs, Serious adverse events (SAEs), selected immune-related adverse events, weighted toxicity score (WTS), interruption, modification, or discontinuation of atezolizumab regimen due to AEs, 4. Change from baseline in Global Health Status score/Quality of Life score (GHS/QoL) from the European Organisation for Research and Treatment of Cancer (EORTC) item library 6 (IL6) GHS/QoL, 5. Change from baseline in EuroQoL 5-Dimension, 5-Level Questionnaire (EQ-5D-5L) index-based and visual analogue Scale (VAS) instrument, 6. Change from baseline in the mean symptom severity score from the MDASI Core Items, 7. Incidence and severity of adverse events assessed as related to device use and adverse device effects, 8. Incidence, nature, and severity of anti-cancer treatment associated AEs as described in the secondary efficacy objectives, 9. Incidence, nature, and severity of all Atezolizumab SC associated AEs graded according to the NCI-CTCAE v5.0 with additional analyses on: - Grade ≥ 3 AEs - SAEs

Source: https://euclinicaltrials.eu/ctis-public/view/2023-504342-55-00